EU clinical trial 2023-508458-25-00: A Phase IIb/III, Double-Blind, Randomised, Active-Controlled, Multi-Center, Non-Inferiority Clinical Trial, to assess the safety and immunogenicity of a booster vaccination with an adapted recombinant protein RBD fusion homodimer candidate (PHH-1V81) against SARS-CoV-2, in adults vaccinated against COVID-19.
Protocol code: HIPRA-HH-14
Sponsor: Hipra Scientific S.L. (Pharmaceutical company). Phase: Phase II and Phase III (Integrated). Countries: Spain (ended).
Therapeutic area(s): Diseases [C] - Virus Diseases [C02]
Gender: Female, Male. Age: 18-64 years, 65+ years. Enrolment: 612.
Status: Ended. Start date (EU): 2023-11-13. End date (EU): 2024-06-17. Decision date: 2023-11-13. Results received: Yes. Last updated: 2024-02-08.

Condition(s): COVID-19 disease
Product: Comirnaty Omicron XBB.1.5 30 micrograms/dose dispersion for injection COVID-19 mRNA Vaccine (nucleoside modified), SARS-COV-2 VIRUS, VARIANTS B.1.351-B.1.1.7, SPIKE PROTEIN, RECEPTOR BINDING DOMAIN FUSION HETERODIMER

Primary endpoint: Number, percentage, and characteristics of solicited local and systemic reactions through Day 7 after vaccination., Number, percentage, and characteristics of unsolicited local and systemic adverse events (AEs) through Day 28 after vaccination., Number and percentage of serious adverse events (SAEs) through the end of the study., Number and percentage of adverse events of special interest (AESI) through the end of the study., Number and percentage of medically attended adverse events (MAAE) through Day 28 and related MAAEs through the end of the study., Grade 3 and 4 changes from baseline in safety laboratory parameters through the end of the study., Neutralisation titre against Omicron XBB.1.16 variant measured as inhibitory concentration 50 (IC50) by PBNA and reported as reciprocal concentration for each individual sample and geometric mean titre (GMT) for treatment group comparison at Baseline and at Day 14.
Endpoint(s): Neutralisation titre against Wuhan, Omicron BA.1 and Omicron XBB.1.5 variants measured as inhibitory concentration 50 (IC50) by PBNA and reported as reciprocal concentration for each individual sample and GMT for treatment group comparison at Baseline and at Days 14, 91 and 182., Neutralisation titre against Omicron XBB.1.16 variant measured as inhibitory concentration 50 (IC50) by PBNA and reported as reciprocal concentration for each individual sample and GMT for treatment group comparison at Days 91 and 182., Percentage of subjects experiencing an increase ≥4-fold in neutralizing antibody titres against Wuhan, Omicron BA.1, Omicron XBB.1.5 and Omicron XBB.1.16 variants measured as inhibitory concentration 50 (IC50) by PBNA for descriptive analysis, from Baseline to Day 14 in both vaccine arms., Geometric mean fold rise (GMFR) in neutralising antibodies titres against Wuhan, Omicron BA.1, Omicron XBB.1.5 and Omicron XBB.1.16 variants for descriptive analysis, from Baseline to Day 14 in both vaccine arms., Binding antibodies titre measured for each individual sample and GMT for treatment group comparison at Baseline and Days 14, 91 and 182., Percentage of subjects experiencing an increase of ≥2-fold in total binding antibody titres against SARS-CoV-2 measured by ECLIA from Baseline to Day 14 for descriptive analysis in both vaccine arms., Number of confirmed COVID-19 cases from ≥14 days after vaccination and through the end of the study for descriptive analysis in both vaccine arms., Number of confirmed COVID-19 severe cases from ≥14 days after vaccination and through the end of the study for descriptive analysis in both vaccine arms., T-cell-mediated response to the SARS-CoV-2 S glycoprotein as measured by whole PBMC stimulation by ELISpot at Baseline and at Day 14 for descriptive analysis in a subset of participants from both vaccine arms 2.

Source: https://euclinicaltrials.eu/ctis-public/view/2023-508458-25-00